EU clinical trial 2025-520554-11-00: A Double-blind, Randomized,Placebo-controlled, Multicenter Study Assessing Olpasiran Use to Prevent First Major Cardiovascular Events in Participants with Elevated Lipoprotein(a)
Protocol code: 20230222
Sponsor: Amgen Inc. (Pharmaceutical company). Phase: Therapeutic confirmatory (Phase III). Countries: Spain (authorised, recruitment pending), Hungary (authorised, recruitment pending), Portugal (authorised, recruitment pending), Greece (authorised, recruitment pending), Germany (authorised, recruitment pending), Italy (authorised, recruitment pending), Austria (authorised, recruitment pending), Ireland (authorised, recruitment pending), Romania (authorised, recruitment pending), Slovakia (authorised, recruitment pending), Netherlands (authorised, recruitment pending), Czechia (authorised, recruitment pending), Bulgaria (authorised, recruitment pending), Denmark (authorised, recruitment pending), France (authorised, recruitment pending), Poland (authorised, recruitment pending), Belgium (authorised, recruitment pending).
Therapeutic area(s): Diseases [C] - Cardiovascular Diseases [C14]
Gender: Female, Male. Age: 18-64 years, 65+ years. Enrolment: 3800.
Status: Authorised, recruitment pending. Decision date: 2025-09-22. Results received: No. Last updated: 2025-09-29.
Decision dates by country: AT: 2025-09-22, BE: 2025-09-23, BG: 2025-09-29, CZ: 2025-09-24, FR: 2025-09-22, DE: 2025-09-25, GR: 2025-09-25, HU: 2025-09-26, IE: 2025-09-26, IT: 2025-09-26, PT: 2025-09-22, RO: 2025-09-29, ES: 2025-09-26, NL: 2025-09-29, PL: 2025-09-27, SK: 2025-09-22, DK: 2025-09-22

Condition(s): Cardiovascular Disease
Product: Placebo for AMG 890

Primary endpoint: Time to CHD death, myocardial infarction, or urgent coronary revascularization, whichever occurs first
Endpoint(s): Time to cardiovascular death, myocardial infarction, or ischemic stroke, whichever occurs first, Time to cardiovascular death, myocardial infarction, urgent coronary revascularization, or ischemic stroke, whichever occurs first, Percent change from baseline to week 48 Lp(a) levels

Source: https://euclinicaltrials.eu/ctis-public/view/2025-520554-11-00